EU clinical trial 2025-521124-29-00: Phase 2/3 Open Label Randomized Study of Telisotuzumab Adizutecan, Monotherapy or in Combination with Osimertinib, Compared to Standard of Care in Subjects with Locally Advanced or Metastatic EGFR-Mutated Non-Squamous Non-Small Cell Lung Cancer After Progression on a Third-Generation EGFR TKI - AndroMETa-Lung-713
Protocol code: M25-713
Sponsor: AbbVie Deutschland GmbH & Co. KG (Pharmaceutical company). Phase: Phase II and Phase III (Integrated). Countries: Portugal (ongoing, recruiting), Italy (ongoing, recruiting), Spain (ongoing, recruiting), Poland (ongoing, recruiting), Netherlands (ongoing, recruiting), Germany (ongoing, recruiting), Belgium (ongoing, recruiting), Austria (ongoing, recruiting), France (ongoing, recruiting).
Therapeutic area(s): Diseases [C] - Neoplasms [C04]
Gender: Female, Male. Age: 18-64 years, 65+ years. Enrolment: 193.
Status: Ongoing, recruiting. Start date (EU): 2026-02-13. Decision date: 2026-02-09. Results received: No. Last updated: 2026-08-03.
Decision dates by country: FR: 2026-02-16, ES: 2026-02-16, AT: 2026-02-16, IT: 2026-02-11, PT: 2026-02-09, NL: 2026-02-09, PL: 2026-02-16, BE: 2026-02-10, DE: 2026-02-10

Condition(s): Non-Small Cell Lung Cancer
Product: CARBOPLATIN, AMIVANTAMAB, Telisotuzumab adizutecan, CARBOPLATIN, CISPLATIN, CISPLATIN, OSIMERTINIB, PEMETREXED, PEMETREXED, PEMETREXED, OSIMERTINIB, CISPLATIN, AMIVANTAMAB, CARBOPLATIN

Primary endpoint: Phase 2: Objective Response (OR) Assessed by Blinded Independent Central Review (BICR), Phase 3: Progression-Free Survival (PFS) as assessed by BICR
Endpoint(s): Phase 2 and 3: Overall Survival (OS) as assessed by BICR, Phase 2: PFS as assessed by BICR, Phase 2 and 3: Duration of Response (DoR) as Assessed by the BICR per Response Evaluation Criteria in Solid Tumors (RECIST) version 1.1, Phase 2 and 3: Disease Control (DC) as Assessed by the BICR per RECIST v1.1, Phase 3: OR Assessed by BICR, Phase 3: Percentage of Participants with Change from Baseline in Physical Functioning as Measured by the European Organization for Research and Treatment of Cancer Quality of Life Core Questionnaire (EORTC QLQ-C30), Phase 3: Percentage of Participants with Change from Baseline in Key Lung Cancer Symptoms as Measured by the European Organization for Research and Treatment of Cancer Quality of Life Questionnaire Lung Cancer Module 13 (EORTC QLQLC13), Phase 3: Percentage of Participants with Change from Baseline in GHS/QoL as measured by the EORTC QLQ-C30, Phase 3: Percentage of Participants with Change from Baseline in Physical Functioning as Measured by the European Organization for Research and Treatment of Cancer Quality of Life Core Questionnaire (EORTC QLQ-C30)

Source: https://euclinicaltrials.eu/ctis-public/view/2025-521124-29-00